EU clinical trial 2023-505160-12-00: A Phase III, single arm, multicentre study to evaluate the efficacy and safety of ropeginterferon alfa-2b in essential thrombocythaemia patients who are intolerant or refractory to or not eligible for other cytoreductive treatments
Protocol code: ROP-ET
Sponsor: Aop Orphan Pharmaceuticals GmbH (Pharmaceutical company). Phase: Therapeutic confirmatory (Phase III). Countries: Spain (ongoing, recruitment ended), Germany (ongoing, recruitment ended), Romania (ongoing, recruitment ended), Czechia (ongoing, recruitment ended), France (ongoing, recruitment ended), Poland (ongoing, recruitment ended), Italy (ongoing, recruitment ended), Hungary (ongoing, recruitment ended), Austria (ongoing, recruitment ended), Greece (ongoing, recruitment ended).
Therapeutic area(s): Diseases [C] - Neoplasms [C04]
Gender: Female, Male. Age: 18-64 years, 65+ years. Enrolment: 132.
Status: Ongoing, recruitment ended. Start date (EU): 2023-12-04. Decision date: 2023-10-25. Results received: No. Last updated: 2025-09-18.
Decision dates by country: CZ: 2023-10-25, GR: 2024-03-22, DE: 2023-10-30, HU: 2023-10-25, AT: 2023-10-30, FR: 2023-10-25, RO: 2023-10-30, IT: 2023-10-25, PL: 2023-10-30, ES: 2023-10-27

Condition(s): Essential Thrombocythaemia
Product: Besremi 500 micrograms/0.5 mL solution for injection in pre-filled pen, Besremi 250 micrograms/0.5 mL solution for injection in pre-filled pen

Primary endpoint: Rate of disease response at month 12 according to modified ELN Criteria: 1. Durable (≥3 months) peripheral blood count remission (PLTs ≤400 x 10^9/L AND WBC <10 x 10^9/L), AND 2. Absence of haemorrhagic or thrombotic events and disease progression, AND 3. Absence or Non-progression in disease-related signs, AND 4. Durable (for at least 3 months) large symptoms improvement or maintenance of non-progression based on the MPN-SAF TSS
Endpoint(s): Response at month 9, 18, 24, 30 and 36, Longitudinal changes in the ELN response rates over 12 months, Time to first response (as defined by ELN criteria), Duration of first response (as defined by ELN criteria), Duration of first durable response (as defined by ELN criteria), Time to first peripheral blood count remission response, Duration of first durable peripheral blood count remission response, Occurrence of thromboembolic and bleeding events, Occurrence of disease progression, Symptomatic improvement assessed by EQ-5D-5L questionnaire, Symptomatic improvement assessed by the 10-item MPN-SAF TSS, Change in inflammation markers over time, Change in CALR, MPL, or JAK2 allelic burden over time

Source: https://euclinicaltrials.eu/ctis-public/view/2023-505160-12-00